EU clinical trial 2023-507674-41-00: A phase I study of [177Lu]Lu-EVS459 in patients with ovarian and lung cancers
Protocol code: CGIZ943A12101
Sponsor: Novartis Pharma AG (Pharmaceutical company). Phase: Human Pharmacology (Phase I)- First administration to humans. Countries: Spain (ended), Netherlands (ended), Germany (ended), France (ended), Italy (ended).
Therapeutic area(s): Diseases [C] - Neoplasms [C04]
Gender: Female, Male. Age: 18-64 years, 65+ years. Enrolment: 58.
Status: Ended. End date (EU): 2025-02-27. End date: 2025-07-10. Decision date: 2024-11-05. Results received: No. Last updated: 2025-01-23.
Decision dates by country: NL: 2024-11-11, FR: 2024-11-05, IT: 2024-11-07, ES: 2024-11-06, DE: 2024-11-06

Condition(s): Advanced high-grade serous ovarian cancer (OC), Locally advanced unresectable or metastatic non-squamous non-small cell lung carcinoma (NSCLC)

Source: https://euclinicaltrials.eu/ctis-public/view/2023-507674-41-00